EU clinical trial 2024-518909-18-00: Efficacy and safety of early switching to dolutegravir/lamivudine (DTG/3TC) from INSTI-based three-drug regimens in HIV-1-infected adults previously naïve who achieve virological suppression
Protocol code: EDOLAS
Sponsor: Societa Italiana Di Malattie Infettive E Tropicali SIMIT (Laboratory/Research/Testing facility). Phase: Therapeutic confirmatory (Phase III). Countries: Italy (ongoing, recruitment ended).
Therapeutic area(s): Diseases [C] - Virus Diseases [C02]
Gender: Female, Male. Age: 18-64 years, 65+ years. Enrolment: 440.
Status: Ongoing, recruitment ended. Start date (EU): 2021-03-23. Decision date: 2024-12-16. Results received: No. Last updated: 2026-05-08.

Condition(s): HIV-1 infected individuals currently taking an INSTI-based three-drug first-line regimen for less than 18 months and who have been virologically suppressed with HIV-1 RNA <50 copies/mL
Product: Dovato 50 mg/300 mg film-coated tablets

Primary endpoint: • Proportion of participants with virological rebound (viral load ≥50 copies/mL or premature discontinuations, irrespective of reason, with last viral load ≥50 copies/mL) at week 48.
Endpoint(s): Proportion of participants with HIV-1 RNA <50 copies/mL at week 48 (FDA Snapshot algorithm), Time to virological rebound (defined as the first of two consecutive HIV-1 RNA >=50 copies/mL), Changes in CD4+ and CD8+ T-lymphocyte counts (absolute and percentage), and in CD4+/CD8+ ratio (as a measure of immune activation) in the peripheral blood from baseline to week 48 and 96., Proportion of participants developing resistance-conferring mutations (to any drug class) by genotypic resistance test (GRT) in plasma or proviral DNA (in case of low viremia levels, <200 copies/mL) at protocol-defined virological failure (PDVF) will be cumulatively described throughout the study period., Viral minority variants harboring resistance associated mutations (to any drug class) at the time of PDVF will be characterized in plasma or in proviral DNA (in case of low viremia levels, <200 copies/mL) by next generation sequencing. For the minority resistant variants detected (prevalence >1%), their resistance viral burden will be also evaluated, Clinical and laboratory safety parameters; a descriptive analysis of all reported AEs and a quantitative analysis of AEs leading to treatment interruption/change will be used to evaluate long-term tolerability of the simplification treatment., Changes in fasting lipids (TC, LDL, HDL, non-HDL, TC/HDL) from baseline to w48 and 96. • Absolute changes as well as proportion of participants above clinically relevant thresholds will be used to evaluate the change of metabolic parameters over time. • Changes of self-reported adherence level and proportion of participants with different adherence level (95%; 90%; 80%) from baseline to week 48 and 96., Change in neuropsychiatric questionnaire scores, assessing mood, anxiety, sleep quality, and suicidality from baseline to week 24, 48 and 96., Virological Sub-study Changes in residual viremia (limit of detection: 3 copies/mL) from baseline to week 24 and 48. Percentage of participants with residual viremia at week 24 and 48. Impact of residual viremia at baseline on virological response. • Change in total HIV-1 DNA in PBMCs from baseline to week 24 and 48. • Impact of total DNA at baseline on virological response. • Change in level of cell-associated HIV-1 RNA in PBMCs from baseline to week 24 and 48., •Impact of total DNA at baseline on virological response.•Change in level of cell-associated HIV-1 RNA in PBMCs from baseline to week 24 and 48. •Impact of cell-associated HIV-1 RNA in PBMCs at baseline on virological response. Correlations between cell-associated HIV-1 RNA in PBMCs,total HIV DNA,and RNA levels.Characterization of minority RT integrase resistance mutations(at >1% prevalence)and their relative abundance in PBMCs at baseline, and their impact on virological failure at 24 and 48wk, Immunological Sub-study •Impact of regimen switching on the percentage of activated(%CD38+DR+),senescent(CD28-CD57+)T-cell lymphocytes and on T helper profile(Th1, Th2,TH9, Th17, Th21);Impact of regimen switching on different B cell (naïve, memory and activated),NK and monocytes subsets and on regulatory cells (Treg and MDSC);. •Impact of regimen switching on the Principal Component analysis of immunological markers • Impact of regimen switching on inflammation and pro-coagulation markers, Renal bone and weight Sub-study Changes in urinary tubular damage markers [alpha1-microglobulin, beta2-microglobulin, retinal binding protein (RBP) and albumin-creatinine ratio (ACR)], from baseline to week 24 and 48. • BMD change by DXA scan. • Enrolled patients may also undergo only part of the evaluations planned for the substudy, Neurologic Sub-study • Change in neurocognitive performance assessed by a standardized neuropsychological battery (NPZ-14) from baseline to week 48 and 96. • Change in plasma NFL concentration from baseline to week 48 and 96, PROs and QoL Sub-study Change in QoL and PROs items from baseline to week 48 and 96 by standardized validate self-reported questionnaires.

Source: https://euclinicaltrials.eu/ctis-public/view/2024-518909-18-00